EU clinical trial 2023-503763-42-00: A Phase 3, Randomized, Observer-Blind, Controlled, Multicenter, Clinical Study to Evaluate Immunogenicity and Safety of a High-Dose MF59-Adjuvanted Quadrivalent Subunit Cell-derived Influenza Vaccine (aQIVc HD) in Comparison with a Non-adjuvanted Quadrivalent Recombinant Influenza Vaccine (QIVr) and an MF59-Adjuvanted Quadrivalent Subunit Egg-derived Influenza Vaccine (aQIV), in Adults Aged 50 Years and Older.
Protocol code: V201_03
Sponsor: Seqirus UK Limited (Pharmaceutical company). Phase: Therapeutic confirmatory (Phase III). Countries: Denmark (ended), Estonia (ended), Germany (ended).
Therapeutic area(s): Diseases [C] - Virus Diseases [C02]
Gender: Female, Male. Age: 18-64 years, 65+ years. Enrolment: 2100.
Status: Ended. Start date (EU): 2023-11-03. End date (EU): 2025-05-16. End date: 2025-05-16. Decision date: 2023-09-25. Results received: Yes. Last updated: 2024-09-27.
Decision dates by country: EE: 2023-09-27, DK: 2023-09-25, DE: 2023-09-28

Condition(s): Healthy individuals or individuals with stable comorbidities which increase their risk of complications from influenza infection.
Product: A/DARWIN/9/2021 (H3N2) - LIKE STRAIN (A/DARWIN/6/2021, IVR-227), adjuvanted Quadrivalent Subunit Inactivated Cell-derived Influenza Vaccine, B/PHUKET/3073/2013-LIKE STRAIN (B/PHUKET/3073/2013, BVR-1B), INFLUENZA VIRUS B/AUSTRIA/1359417/2021-LIKE STRAIN (B/AUSTRIA/1359417/2021, BVR-26), INFLUENZA B VIRUS YAMAGATA LINEAGE HAEMAGGLUTININ, RECOMBINANT, INFLUENZA A VIRUS SUBTYPE H1N1 HAEMAGGLUTININ, RECOMBINANT, A/VICTORIA/2570/2019 (H1N1)PDM09-LIKE STRAIN (A/VICTORIA/2570/2019, IVR-215), INFLUENZA A VIRUS SUBTYPE H3N2 HAEMAGGLUTININ, RECOMBINANT, INFLUENZA B VIRUS VICTORIA LINEAGE HAEMAGGLUTININ, RECOMBINANT

Primary endpoint: 1.Immunogenicity responses of 3 lots of aQIVc HD compared in pairs in terms of Day 29 ratio of Geometric Mean Titer (GMTr), from antibodies measured via HI assay using cell-derived target viruses for the 4 vaccine strains. 2. Immunogenicity responses of aQIVc HD vs QIVr and aQIV in terms of: - Day 29 GMT and GMTr - Day 1 to Day 29 Seroconversion rate (SCR) and SCR difference from antibodies measured via HI assay using cell-derived target viruses for the 4 vaccine strains.
Endpoint(s): Immunogenicity responses of aQIVc HD in comparison with aQIV vaccine in subjects aged 65 years and older in terms of Day 29 Geometric mean titer (GMT) and GMT ratio of antibodies measured via HI assay using cell-derived target viruses for the A/H1N1, A/H3N2, B/Yamagata, and B/Victoria vaccine strains, and Day 1 to Day 29 Seroconversion rate (SCR) and SCR difference., Immunogenicity responses of aQIVc HD, QIVr and aQIV vaccines in terms of Day 29 Geometric mean titer (GMT) and GMT ratio of antibodies measured via HI assay using cell-derived target viruses for the A/H1N1, A/H3N2, B/Yamagata, and B/Victoria vaccine strains, overall and by age subgroup., Safety of aQIVc HD, QIVr and aQIV in terms of percentage of subjects with: - Solicited Local and Systemic Reactions from Day 1 to Day 7. - Unsolicited Adverse Events from Day 1 to Day 29. - Serious Adverse Events, AEs Leading to Withdrawal, Adverse Events of Special Interest and Medically Attended Adverse Events from Day 1 to Day 365.

Source: https://euclinicaltrials.eu/ctis-public/view/2023-503763-42-00